EU clinical trial 2024-518190-34-00: Characterization of the immune response in immunosuppressed patients with rheumatic diseases, including to the recombinant zoster vaccine
Protocol code: RC31/24/0156
Sponsor: Centre Hospitalier Universitaire De Toulouse (Hospital/Clinic/Other health care facility). Phase: Therapeutic use (Phase IV). Countries: France (ongoing, recruiting).
Therapeutic area(s): Diseases [C] - Musculoskeletal Diseases [C05]
Gender: Female, Male. Age: 18-64 years, 65+ years. Enrolment: 60.
Status: Ongoing, recruiting. Start date (EU): 2026-02-16. Decision date: 2025-05-28. Results received: No. Last updated: 2025-09-04.

Condition(s): rheumatic disease
Product: UPADACITINIB, METHOTREXATE, FILGOTINIB, BARICITINIB, TOFACITINIB, METHOTREXATE, Shingrix powder and suspension for suspension for injection Herpes zoster vaccine (recombinant, adjuvanted)

Primary endpoint: Geometric mean titer (GMT) of gE-specific IgG measured by ELISA at day 90, Mean of gE-specific CD4+ T cells expressing at least 2 markers (CD40L, IFN-gamma, IL-2, TNF-alpha) measured at day 90 per millions of T cells, measured by flow cytometry at day 90
Endpoint(s): Frequency of self-reported clinical symptoms occurring 7 days after each vaccination, Increase in pro-inflammatory markers (cytokines, CRP) between day 1 and day 0 (first vaccination) and between day 60 and day 61 (second vaccination), Differential expression of innate and adaptive immune response genes measured by RNA sequencing (RNAseq), with the aim to compare gene profiles before and after vaccination (day 0 vs day 1, day 60 vs day 61), differences between responses to first, second (day 1 vs day 61) or subsequent doses, and after 1 month following the vaccination, Kinetics of GMT of gE-specific IgG measured at day 0, 60, 90 and 360 to assess the persistence of the antibody response, Kinetics of gE-specific CD4+ T cells expressing at least 2 activation markers (CD40L, IFNg, IL-2, TNFa) measured at day 0, 90, and 360 to assess the persistence of the T cell responses, Change in disease activity evaluated at each visit using the Rheumatoid Arthritis Disease Activity Index (RADAI)(Stucki et al. 1995; Castrejón, Yazici, and Pincus 2013) for rheumatoid arthritis and psoriatic arthritis, the Bath Ankylosing Spondylitis Disease Activity Index (BASDAI)(Garrett et al. 1994) for axial spondylarthritis (Appendix 2) and patient global assessment on a 0-10 scale., Monitoring of episodes of shingles throughout the study period, ADCC (cytotoxicity), levels of isotypes, avidity levels before and after vaccination, Differential expression of genes and epigenetic changes of specific innate cells (monocytes or NK cells), 1 month and 1 year post vaccination (compared to before vaccination), Changes in memory phenotypes, activation and transcription marker levels, TCR repertoire after RZV vaccination., Differences and similarities in levels of immune and inflammatory response post RZV vaccination and COVID-19 mRNA vaccines in individuals who were enrolled in study “Immunogenicity of RNA-based COVID-19 vaccines in patients treated with immunosuppressive drugs – a prospective observational cohort study” (CCER ##2021-00430), The level of JAKi will be measured by mass-spectrometry using an established and quantitative method and used to correlate with the vaccine response, including adaptive responses and reactogenicity

Source: https://euclinicaltrials.eu/ctis-public/view/2024-518190-34-00